EU clinical trial 2024-513513-12-00: A Phase 3, Open-Label, Randomized, Active-Controlled, Multicenter Study to Evaluate the Efficacy and Safety of Pemigatinib Versus Gemcitabine Plus Cisplatin Chemotherapy in First-Line Treatment of Participants With Unresectable or Metastatic Cholangiocarcinoma With FGFR2 Rearrangement (FIGHT-302)
Protocol code: INCB 54828-302
Sponsor: Incyte Corp. (Pharmaceutical company). Phase: Therapeutic confirmatory (Phase III). Countries: Germany (ended), Belgium (ended), Italy (ended), Spain (ended), Netherlands (ended), Sweden (ended), Austria (ended), France (ended).
Therapeutic area(s): Diseases [C] - Neoplasms [C04]
Gender: Female, Male. Age: 18-64 years, 65+ years. Enrolment: 110.
Status: Ended. Start date (EU): 2019-01-06. End date (EU): 2025-06-03. End date: 2025-07-08. Decision date: 2024-08-22. Results received: Yes. Last updated: 2025-07-23.
Decision dates by country: BE: 2024-08-26, FR: 2024-08-23, SE: 2024-08-22, NL: 2024-08-22, ES: 2024-08-23, AT: 2024-08-26, IT: 2024-08-27, DE: 2024-08-26

Condition(s): Cholangiocarcinoma
Product: Pemazyre 9 mg tablets, Pemazyre 13.5 mg tablets, Pemazyre 4.5 mg tablets, Gemcitabine 1000 mg, powder for solution for infusion, Cisplatin Ebewe 1 mg/ml – Konzentrat zur Herstellung einer Infusionslösung

Primary endpoint: PFS: defined as the time from date of randomization until date of disease progression (according to RECIST v1.1 and assessed by an ICR) or death, whichever occurs first.
Endpoint(s): ORR (CR + PR): defined as the proportion of participants with best overall response of CR or PR per RECIST v1.1 as assessed by an ICR., OS: defined as the time from date of randomization until death due to any cause., DOR: defined as the time from the date of the first assessment of CR or PR until the date of the first disease progression by an ICR per RECIST v1.1 or death, whichever occurs first., DCR (CR + PR + SD): defined as the proportion of participants who achieved best overall response of CR, PR, or SD per RECIST v1.1 as assessed by an ICR., Occurrence of TEAEs and treatment-related AEs according to NCI CTCAE v5.0, physical findings, and vital sign, laboratory, and ECG changes., QoL questionnaire data (EQ-5D, EORTC QLQ-30, and BIL-21).

Source: https://euclinicaltrials.eu/ctis-public/view/2024-513513-12-00